EU clinical trial 2023-504869-23-00: A Phase 3b/4 Randomized, Blinded, Treat-to-Target and Dose-Flexibility Study of Upadacitinib in Adult Subjects with Moderate to Severe Atopic Dermatitis (Flex-Up)
Protocol code: M22-000
Sponsor: AbbVie Deutschland GmbH & Co. KG (Pharmaceutical company). Phase: Phase III and phase IV (Integrated). Countries: Netherlands (ended), Spain (ended), Portugal (ended), Germany (ended), Hungary (ended), Belgium (ended), Slovakia (ended), Italy (ended), Bulgaria (ended), Poland (ended).
Therapeutic area(s): Diseases [C] - Immune System Diseases [C20]
Gender: Female, Male. Age: 18-64 years. Enrolment: 272.
Status: Ended. Start date (EU): 2023-05-31. End date (EU): 2024-08-07. End date: 2024-08-15. Decision date: 2023-09-07. Results received: Yes. Last updated: 2024-07-15.
Decision dates by country: SK: 2023-09-13, DE: 2023-09-13, ES: 2023-09-11, BG: 2023-10-23, PL: 2023-10-20, IT: 2023-10-03, HU: 2023-09-12, PT: 2023-09-11, BE: 2023-09-13, NL: 2023-09-07

Condition(s): Dermatitis atopic
Product: Upadacitinib, Upadacitinib

Primary endpoint: Achievement of EASI 90 at Week 24
Endpoint(s): Achievement of EASI 75 / 100 at Week 24., Achievement of EASI 75 / 90 / 100 at Week 12., Achievement of EASI 90 and a Worst Pruritus NRS of 0 or 1 for subjects with Worst Pruritus NRS > 1 at Baseline at Week 12 and Week 24., Achievement of a vIGA-AD of 0 or 1 at Week 12., Achievement of vIGA-AD of 0 or 1 at Week 24., Achievement of an improvement (reduction) in Worst Pruritus NRS ≥ 4 for subjects with Worst Pruritus NRS ≥ 4 at Baseline at Week 12., Achievement of an improvement (reduction) in Worst Pruritus NRS ≥ 4 for subjects with Worst Pruritus NRS ≥ 4 at Baseline at Week 24., Achievement of Worst Pruritus NRS of 0 or 1 for subjects with Worst Pruritus NRS > 1 at Baseline at Week 12., Achievement of Worst Pruritus NRS of 0 or 1 for subjects with Worst Pruritus NRS > 1 at Baseline at Week 24., Achevement of an improvement (reduction) from Baseline in DLQI ≥4 for subjects with DLQI ≥ 4 at Baseline at Week 12., Achievement of an improvement (reduction) from Baseline in DLQI ≥4 for subjects with DLQI ≥ 4 at Baseline at Week 24., Achievement of DLQI 0/1 for subjects with DLQI > 1 at Baseline at Week 12., Achievement of DLQI 0/1 for subjects with DLQI > 1 at Baseline at Week 24.

Source: https://euclinicaltrials.eu/ctis-public/view/2023-504869-23-00